EU clinical trial 2025-524027-49-00: An open-label, multicentric, phase 1 study to evaluate the safety, tolerability, and radiation dosimetry of endogenous radioligand therapy with (¹⁷⁷Lu)Lutetiumvipivotidtetraxetan in women with metastatic triple negative breast cancer (TNBC)
Protocol code: 25-246
Sponsor: Universitaetsklinikum Aachen AöR (Hospital/Clinic/Other health care facility). Phase: Human Pharmacology (Phase I)- Other. Countries: Germany (authorised, recruitment pending).
Therapeutic area(s): Not possible to specify
Gender: Female. Age: 18-64 years, 65+ years. Enrolment: 18.
Status: Authorised, recruitment pending. Decision date: 2026-07-14. Results received: No. Last updated: 2026-07-14.

Condition(s): Metastatic triple negative breast cancer
Product: Pluvicto 1 000 MBq/mL solution for injection/infusion, Locametz 25 micrograms kit for radiopharmaceutical preparation

Primary endpoint: Incidence of DLTs during the DLT observation period (DLT and DLT observation period as defined in protocol section 2.4.1), Co-primary safety endpoint: Frequency and nature of treatment-emergent adverse events (TEAEs).

Source: https://euclinicaltrials.eu/ctis-public/view/2025-524027-49-00